EU clinical trial 2024-514110-12-00: A Phase 1/2, Randomized, Double-Masked, Placebo-Controlled, Multicenter Study to Assess the Safety, Pharmacokinetics, and Efficacy of AMG 732 in Healthy Subjects and Subjects with Moderate-to-Severe Active Thyroid Eye Disease
Protocol code: 20230302
Sponsor: Amgen Inc. (Pharmaceutical company). Phase: Phase I and Phase II (Integrated)- First administration to humans. Countries: France (ongoing, recruitment ended), Spain (ongoing, recruitment ended), Italy (ongoing, recruitment ended), Poland (ongoing, recruitment ended), Germany (ongoing, recruitment ended), Greece (ongoing, recruitment ended).
Therapeutic area(s): Diseases [C] - Eye Diseases [C11]
Gender: Female, Male. Age: 18-64 years, 65+ years. Enrolment: 20.
Status: Ongoing, recruitment ended. Start date (EU): 2025-10-22. Decision date: 2025-09-15. Results received: No. Last updated: 2026-05-13.
Decision dates by country: ES: 2025-09-16, PL: 2025-09-19, FR: 2025-09-16, IT: 2025-10-22, DE: 2025-09-24, GR: 2025-12-11

Condition(s): Thyroid Eye Disease
Product: Placebo for AMG 732 will consist of site-sourced normal saline in sterile single-use vials or ampoules, AMG 732

Primary endpoint: Change from baseline at week 9999 in proptosis measurement by an exophthalmometer in the study eye
Endpoint(s): Subject incidence of treatment-emergent adverse events, including serious adverse events, PK parameters including but not limited to maximum observed concentration (Cmax), time to maximum observed concentration (Tmax), area under the concentration time curve (AUC) over the dosing interval, accumulation following multiple dosing, and if feasible, half-life (t1/2) as data permits., Subject incidence of antidrug antibodies (ADAs), Proptosis response status in the study eye 9999 proptosis in the fellow eye) at week 9999, Mean change from Baseline at Week 9999 in the GO-QoL Visual Functioning (VF) subscale score, Mean change from Baseline at Week 9999 in the GO-QoL Appearance (A) subscale score

Source: https://euclinicaltrials.eu/ctis-public/view/2024-514110-12-00